EU clinical trial 2024-510763-35-00: An Off-Label Single Arm Clinical Study to Evaluate the Efficacy and Safety of doxecitine and doxribtimine in Adult Subjects with Thymidine Kinase 2 (TK2) Deficiency
Sponsor: Hospital Universitario 12 De Octubre (Hospital/Clinic/Other health care facility). Phase: Therapeutic exploratory (Phase II). Countries: Spain (ongoing, recruiting).
Therapeutic area(s): Diseases [C] - Musculoskeletal Diseases [C05]; Diseases [C] - Nervous System Diseases [C10]
Gender: Female, Male. Age: 18-64 years, 65+ years. Enrolment: 15.
Status: Ongoing, recruiting. Start date (EU): 2024-11-05. Decision date: 2024-07-09. Results received: No. Last updated: 2025-06-04.

Condition(s): Organic compound
Product: doxecitine and doxribtimine

Primary endpoint: To evaluate the efficacy of dT+dC in adults with TK2d.
Endpoint(s): To evaluate the safety of dT+dC in adults with TK2d.

Source: https://euclinicaltrials.eu/ctis-public/view/2024-510763-35-00